EU clinical trial 2025-523552-31-00: A Phase 3, Randomized, Double-blind, Placebo-controlled, Multicenter Study of Nipocalimab in Adults with Moderate to Severe Systemic Lupus Erythematosus
Protocol code: 80202135SLE3001
Sponsor: Janssen Cilag International (Pharmaceutical company). Phase: Therapeutic confirmatory (Phase III). Countries: Denmark (ongoing, recruiting), Hungary (ongoing, recruiting), Portugal (ongoing, recruiting), Italy (ongoing, recruiting), Norway (authorised, recruiting), Greece (ongoing, recruiting), Slovakia (authorised, recruiting), Czechia (ongoing, recruiting), France (authorised, recruiting), Poland (ongoing, recruiting), Bulgaria (ongoing, recruiting), Germany (ongoing, recruiting), Spain (ongoing, recruiting), Romania (ongoing, recruiting), Finland (ongoing, recruiting).
Therapeutic area(s): Diseases [C] - Immune System Diseases [C20]
Gender: Female, Male. Age: 18-64 years, 65+ years. Enrolment: 271.
Start date (EU): 2026-05-07. Decision date: 2026-05-05. Results received: No. Last updated: 2026-07-03.
Decision dates by country: BG: 2026-05-11, CZ: 2026-05-05, DK: 2026-05-05, FR: 2026-05-07, DE: 2026-05-05, IT: 2026-05-06, PT: 2026-05-06, RO: 2026-05-11, ES: 2026-05-06, NO: 2026-05-06, PL: 2026-05-08, SK: 2026-05-05, GR: 2026-05-12, FI: 2026-05-12, HU: 2026-05-08

Condition(s): Systemic Lupus Erythematosus
Product: Placebo subcutaneous without Nipocalimab, JNJ-80202135

Primary endpoint: Systemic lupus erythematosus responder index (SRI)-4 composite response at Week 52

Source: https://euclinicaltrials.eu/ctis-public/view/2025-523552-31-00